EU clinical trial 2024-510980-40-00: Debio 0123 in combination with carboplatin and etoposide in adult participants with small cell lung cancer that recurred or progressed after platinum-based therapy.
Protocol code: Debio 0123-SCLC-104
Sponsor: Debiopharm International SA (Pharmaceutical company). Phase: Human Pharmacology (Phase I)- Other. Countries: Spain (ended).
Therapeutic area(s): Diseases [C] - Neoplasms [C04]
Gender: Female, Male. Age: 18-64 years, 65+ years. Enrolment: 50.
Status: Ended. Start date (EU): 2023-03-09. End date (EU): 2026-03-09. End date: 2026-03-10. Decision date: 2024-07-12. Results received: No. Last updated: 2025-11-12.

Condition(s): Small cell lung cancer

Source: https://euclinicaltrials.eu/ctis-public/view/2024-510980-40-00